EU clinical trial 2025-522367-15-00: A Study of LY4257496 in Participants With Cancer (OMNIRAY)
Protocol code: J6C-OX-JKFA
Sponsor: Eli Lilly & Co. (Pharmaceutical company). Phase: Human Pharmacology (Phase I)- First administration to humans. Countries: Germany (authorised, recruitment pending).
Therapeutic area(s): Diseases [C] - Neoplasms [C04]
Gender: Female, Male. Age: 18-64 years, 65+ years. Enrolment: 53.
Status: Authorised, recruitment pending. Decision date: 2026-03-05. Results received: No. Last updated: 2026-07-24.

Condition(s): Breast Neoplasms; Colorectal Neoplasms; Prostate Neoplasm; Endometrial Neoplasms; Neoplasm Metastasis; Stomach Neoplasms; Esophageal Neoplasms

Source: https://euclinicaltrials.eu/ctis-public/view/2025-522367-15-00